EU clinical trial 2025-523280-38-00: An Open-Label, Rollover Study for Participants With Thyroid Eye Disease Previously Enrolled in Amgen-Sponsored AMG 732 Studies and are Primary Proptosis Non-responders or who Relapsed During the Safety Follow-up
Protocol code: 20230294.01
Sponsor: Amgen Inc. (Pharmaceutical company). Phase: Therapeutic exploratory (Phase II). Countries: Spain (ongoing, recruiting), Poland (ongoing, recruiting), France (authorised, recruitment pending), Italy (authorised, recruitment pending).
Therapeutic area(s): Diseases [C] - Eye Diseases [C11]
Gender: Female, Male. Age: 18-64 years, 65+ years. Enrolment: 8.
Start date (EU): 2026-06-09. Decision date: 2026-05-20. Results received: No. Last updated: 2026-08-05.
Decision dates by country: ES: 2026-05-20, FR: 2026-08-04, IT: 2026-08-05, PL: 2026-05-25

Condition(s): Thyroid Eye Disease
Product: AMG 732

Primary endpoint: Proptosis response status in the study eye (responders are defined as participants with a ≥ 2 mm reduction from baseline in the study eye without deterioration [≥ 2 mm increase] of proptosis in the fellow eye) at week 9999
Endpoint(s): PK parameters including but not limited to trough concentration (Ctrough), maximum observed concentration (Cmax), time to maximum observed concentration (tmax), area under the concentration-time curve (AUC) over the dosing interval, and if feasible, half-life (t1/2) as data permits, Incidence of treatment-emergent adverse events, treatment-emergent serious adverse events, adverse events leading to investigational product discontinuation, and events of interest (EOIs), Change from baseline at week 9999 in proptosis measurement by an exophthalmometer in the study eye, Proptosis response status in the study eye at week 9999 -Change from baseline at week 9999 in proptosis measurement by an exophthalmometer in the study eye

Source: https://euclinicaltrials.eu/ctis-public/view/2025-523280-38-00